EU clinical trial 2024-518388-37-00: Ultra-hypofractionated radiotHErapy and concomitant oral RelugOlix for treatment of intermediate risk prostate cancer. (Ultra-HERO)
Protocol code: Ultra-HERO
Sponsor: Fondazione Radioterapia Oncologica Onlus (Hospital/Clinic/Other health care facility). Phase: Therapeutic exploratory (Phase II). Countries: Italy (authorised, recruitment pending).
Therapeutic area(s): Diseases [C] - Neoplasms [C04]
Gender: Male. Age: 18-64 years, 65+ years. Enrolment: 73.
Status: Authorised, recruitment pending. Decision date: 2025-04-03. Results received: No. Last updated: 2026-06-04.

Condition(s): Intermediate risk prostate cancer
Product: RELUGOLIX

Primary endpoint: To assess rate of complete biochemical response after 6 months of treatment, defined as PSA <0.5 ng/ml, in an homogeneous cohort of patients affected by unfavourable intermediate risk localized prostate cancer undergoing prostate radiotherapy (36.25 GY in 5 fractions) + short course oral relugolix.
Endpoint(s): Biochemical relapse free survival (BRFS) at 2 years after end of radiotherapy. Biochemical relapse will be defined as a rise by 2 ng/mL or more above the nadir PSA according to RTOG- ASTRO Phoenix Consensus Conference [Roach 2006], Rate of patients with testosterone recovery at 90 days from the end of ADT treatment (eugonadal level of testosterone will be defined as >150 ng/dL), Rate of patients experiencing non pathological fracture at 2 years, Rate of cardiovascular events at 48 weeks (myocardial infarction and stroke), Erectile disfunction rate measured with IIEF at 2 years after the end of treatment, Quality of life measured with EORTC QLQ-C30 and EORTC QLQ-PR25

Source: https://euclinicaltrials.eu/ctis-public/view/2024-518388-37-00